EU clinical trial 2024-517895-39-00: A study in healthy men to test whether food influences the amount of BI 3731579 in the blood
Protocol code: 1519-0004
Sponsor: Boehringer Ingelheim International GmbH (Pharmaceutical company). Phase: Human Pharmacology (Phase I)- Other. Countries: Germany (ended).
Therapeutic area(s): Not possible to specify
Gender: Male. Age: 18-64 years. Enrolment: 12.
Status: Ended. Start date (EU): 2025-03-17. End date (EU): 2025-04-23. Decision date: 2025-01-27. Results received: No. Last updated: 2025-01-27.

Condition(s): Healthy volunteer trial

Source: https://euclinicaltrials.eu/ctis-public/view/2024-517895-39-00